EU clinical trial 2024-510917-14-00: A Long-Term Extension Trial Investigating the Safety and Efficacy of GTX-102 in Patients with Angelman Syndrome
Protocol code: GTX-102-CL302
Sponsor: Ultragenyx Pharmaceutical Inc. (Pharmaceutical company). Phase: Therapeutic confirmatory (Phase III). Countries: France (ongoing, recruiting), Spain (ongoing, recruiting), Germany (ongoing, recruiting).
Therapeutic area(s): Diseases [C] - Congenital, Hereditary, and Neonatal Diseases and Abnormalities [C16]
Gender: Female, Male. Age: 0-17 years. Enrolment: 38.
Status: Ongoing, recruiting. Start date (EU): 2024-09-03. Decision date: 2024-07-18. Results received: No. Last updated: 2026-02-16.
Decision dates by country: DE: 2024-09-16, ES: 2024-09-20, FR: 2024-07-19

Condition(s): Angelman Syndrome
Product: GTX/UX Diluent and Flush Solution, GTX-102, ELLIOTTS B SOLUTION (buffered intrathecal electrolyte/dextrose injection)

Primary endpoint: Treatment-emergent AEs and SAEs, frequency, severity, and relationship to investigational product throughout the study
Endpoint(s): Change from LTE Month 0 and pretreatment (when available) throughout the study in: • Bayley-4 Cognitive raw score • Bayley-4 Receptive Communication raw score • Bayley-4 Expressive Communication raw score • Bayley-4 Gross Motor raw score • Bayley-4 Fine Motor raw score

Source: https://euclinicaltrials.eu/ctis-public/view/2024-510917-14-00